EU clinical trial 2024-517818-15-00: PROCEADE PanTumor: A Phase 1b/2, Multicenter, Open-Label Study of Anti-CEACAM5 Antibody-Drug Conjugate M9140 in Participants with Advanced Non-Small Cell Lung Cancer (Substudy NSCLC)
Protocol code: MS202329_0010
Sponsor: Merck Healthcare KGaA (Pharmaceutical company). Phase: Phase I and Phase II (Integrated)- Other. Countries: France (ongoing, recruitment ended), Italy (ongoing, recruitment ended), Spain (ongoing, recruitment ended), Austria (ended), Germany (ended).
Therapeutic area(s): Diseases [C] - Neoplasms [C04]
Gender: Female, Male. Age: 18-64 years, 65+ years. Enrolment: 51.
Start date (EU): 2025-06-06. Decision date: 2025-05-05. Results received: No. Last updated: 2025-12-22.
Decision dates by country: IT: 2025-05-05, AT: 2025-05-12, DE: 2025-05-06, ES: 2025-05-06, FR: 2025-05-05

Condition(s): Non-Small Cell Lung Cancer
Product: M9140

Primary endpoint: Objective Response (OR) according to RECIST v1.1 as assessed by Investigators.
Endpoint(s): Number of Participants with Adverse Events (AEs) and Treatment Related AEs., Duration of Response (DoR) according to RECIST v1.1 as assessed by Investigators., Number of Participants with Disease Control., Time to Response according to RECIST v1.1 as assessed by Investigators., Progression-free Survival (PFS) according to RECIST v1.1 as assessed by Investigators., Pharmacokinetic (PK) Plasma Concentrations of M9140., Number of Participants with Anti-Drug Antibodies (ADA) against M9140.

Source: https://euclinicaltrials.eu/ctis-public/view/2024-517818-15-00